EU clinical trial 2024-517184-23-00: A randomized Phase 2, open-label study of mirvetuximab soravtansine in patients with platinum-resistant advanced high-grade epithelial ovarian, primary peritoneal, or fallopian tube cancers with high folate receptor-alpha expression testing 2 schedules of administration for dose optimization, with a separate cohort to determine starting dose in patients with moderate hepatic impairment
Protocol code: IMGN853-0425
Sponsor: AbbVie Deutschland GmbH & Co. KG (Pharmaceutical company). Phase: Therapeutic exploratory (Phase II). Countries: Belgium (ongoing, recruiting), Poland (ongoing, recruiting), France (ongoing, recruiting), Spain (ongoing, recruiting).
Therapeutic area(s): Diseases [C] - Neoplasms [C04]
Gender: Female. Age: 18-64 years. Enrolment: 37.
Status: Ongoing, recruiting. Start date (EU): 2025-10-16. Decision date: 2025-07-31. Results received: No. Last updated: 2026-07-09.
Decision dates by country: PL: 2025-08-11, ES: 2025-11-07, BE: 2025-07-31, FR: 2025-07-31

Condition(s): platinum-resistant advanced high-grade epithelial ovarian, primary peritoneal, or fallopian tube cancers.
Product: Pred Forte 10 mg/ml colirio en suspensión

Primary endpoint: Rates of Grade ≥ 2 treatment-emergent corneal AEs, Objective response rate (ORR), which is defined as the proportion of subjects who achieved a best confirmed complete response (CR) or partial response (PR), as assessed by the Investigator according to Response Evaluation Criteria in Solid Tumors version 1.1 (RECIST v1.1), PK parameters in patients with moderate hepatic impairment versus matching patients with normal hepatic function
Endpoint(s): Rates of treatment-emergent all-grade ocular AEs, Grade ≥ 2 peripheral neuropathy, all-grade infusion reactions, and all-grade pneumonitis, Treatment-emergent adverse events (TEAEs) and changes in laboratory test results, physical examination (PE) results, and vital signs, Duration of response (DOR), defined as the time from initial investigator-assessed response (CR or PR) until progressive disease (PD) as assessed by the investigator or death, whichever occurs first, Progression-free survival (PFS), defined as the time from randomization until investigator-assessed radiological PD or death, whichever occurs first, Overall survival (OS), defined as the time from randomization until death, Cancer antigen 125 (CA-125) response rate per Gynecologic Cancer Intergroup (GCIG) criteria, PK parameters in both schedules, such as maximal concentration (Cmax), area under the concentration-time curve (AUC), trough concentration (Ctrough), volume of distribution at steady state (Vss), time to maximal concentration (Tmax), and terminal half-life (t½); relationships between efficacy/safety endpoints and exposure metrics; covariates on the ER relationships, TEAEs and changes in laboratory test results, PE results, and vital signs

Source: https://euclinicaltrials.eu/ctis-public/view/2024-517184-23-00